EU clinical trial 2025-524876-43-00: HO183 CAR T: A phase III randomized trial comparing academically produced BCMA-directed CAR T-cells (ARI0002h) with standard of care regimen in patients with relapsed/refractory multiple myeloma
Sponsor: Universitair Medisch Centrum Groningen (Hospital/Clinic/Other health care facility). Phase: Therapeutic confirmatory (Phase III). Countries: Netherlands (authorised, recruitment pending).
Therapeutic area(s): Diseases [C] - Neoplasms [C04]
Gender: Female, Male. Age: 18-64 years, 65+ years. Enrolment: 126.
Status: Authorised, recruitment pending. Decision date: 2026-04-29. Results received: No. Last updated: 2026-04-29.

Condition(s): relapsed/refractory multiple myeloma
Product: Kyprolis 60 mg powder for solution for infusion, Kyprolis 30 mg powder for solution for infusion, DARZALEX 1800 mg solution for injection, ENDOXAN omhulde tablet, omhulde tabletten, 50 mg, Cesnicabtagene autoleucel, Kyprolis 10 mg powder for solution for infusion, Dexamethason Teva 4 mg, tabletten, Bortezomib Accord 3.5 mg powder for solution for injection, Empliciti 300 mg powder for concentrate for solution for infusion., Dexamethason Activase 2 mg tabletten, Pomalidomide Accord 4 mg hard capsules, Empliciti 400 mg powder for concentrate for solution for infusion.

Primary endpoint: Progression free survival
Endpoint(s): Safety and toxicity of ARI0002h CAR T-cells and SoC, Overall response rate, Overall and sustained MRD-negativity, MRD-negative CR/sCR and MRD-negative VGPR+, Correlation of MRD-negativity with efficacy endpoints, Best overall response, Duration of response, Overall survival from date of randomization, Patient Reported Outcome/Quality of Life, CAR T-cell expansion, persistence, and T-cell characteristics in ARI0002h-treated patients, PoC CAR T-cell production characteristics, The association of the functional characteristics of the CAR T-cell products with CAR T-cell expansion, persistence, AEs, response rates and PFS, Proportion of successful batches, Production and additional health care costs

Source: https://euclinicaltrials.eu/ctis-public/view/2025-524876-43-00